EU clinical trial 2025-521914-25-00: A Phase 1, Randomized, Double-Blind, Placebo-Controlled, Adaptive Single Ascending Dose Study to Evaluate the Safety, Tolerability, and Pharmacokinetics of CLE-905-AG, a M1/M4 Muscarinic Agonist when administered alone or in conjunction with a Peripheral Muscarinic antagonist, in Healthy Participants
Protocol code: CLE905-FIH-101
Sponsor: Clexio Biosciences Ltd. (Pharmaceutical company). Phase: Human Pharmacology (Phase I)- Other. Countries: France (ended).
Therapeutic area(s): Psychiatry and Psychology [F] - Mental Disorders [F03]
Gender: Female, Male. Age: 18-64 years. Enrolment: 110.
Status: Ended. Start date (EU): 2025-07-31. End date (EU): 2025-12-23. Decision date: 2025-07-30. Results received: No. Last updated: 2025-08-07.

Condition(s): Schizophrenia

Source: https://euclinicaltrials.eu/ctis-public/view/2025-521914-25-00